EU clinical trial 2025-520826-39-00: APROTININ TREATMENT OF ACUTE RESPIRATORY DISTRESS SYNDROME: A MULTICENTER, DOUBLE-BLIND, PLACEBO-CONTROLLED, PHASE III TRIAL
Protocol code: ICI24/00011
Sponsor: Fundacion Del Hospital Nacional De Paraplejicos Para La Investigacion Y La Integracion (Hospital/Clinic/Other health care facility). Phase: Therapeutic confirmatory (Phase III). Countries: Spain (ongoing, recruiting).
Therapeutic area(s): Diseases [C] - Respiratory Tract Diseases [C08]
Gender: Female, Male. Age: 18-64 years, 65+ years. Enrolment: 156.
Status: Ongoing, recruiting. Start date (EU): 2026-06-18. Decision date: 2025-08-14. Results received: No. Last updated: 2026-07-29.
Decision dates by country: ES: 2025-10-01

Condition(s): ACUTE RESPIRATORY DISTRESS SYNDROME
Product: saline solution, Inhaled aprotenin 200 KIU/mL

Primary endpoint: primary efficacy: For the primary endpoint, ventilator-free days (DLVI) will be calculated. A patient will be considered ventilator-free after two consecutive calendar days of unassisted ventilation. These variables will also be assessed at D90 in an exploratory analysis.
Endpoint(s): secondary efficacy: All-cause mortality will be assessed at D28 (primary) and also at D90 and D180. All deaths will be recorded as EAS up to D180. The location of the patient at the time of death (ICU or hospital) will also be recorded. SOFA, renal support, vasoactive support, respiratory functioning, persistent weakness and neuropsychological disorders (D180)., safety: Adverse Event Evaluation, Causality, Adverse Event in Clinical Laboratory, Adverse Event Recording, Serious Adverse Event Reporting, Adverse Event Follow-Up, Adverse Event Monitoring, laboratory: Blood samples will be taken for biochemistry and hematology at screening, prior to dosing on D1 (baseline) and daily until D28 while the patient is in the ICU., vital signs: - Blood pressure (systolic, diastolic and mean; mmHg): to be recorded through an arterial line. - Heart rate (HR; bpm): measured according to clinical practice in each ICU. - Total respiratory rate (breaths per minute). - Temperature (°C) - ECG

Source: https://euclinicaltrials.eu/ctis-public/view/2025-520826-39-00